EU clinical trial 2025-523342-27-00: A Phase 2, randomized, placebo-controlled, double-blind clinical study to evaluate efficacy and safety of LAD603 in adult subjects with severe to very severe alopecia areata
Protocol code: M-00223-20
Sponsor: Almirall S.A. (Pharmaceutical company). Phase: Therapeutic exploratory (Phase II). Countries: Bulgaria (ongoing, recruiting), Romania (ongoing, recruiting), Poland (ongoing, recruiting), Germany (ongoing, recruiting), Spain (ongoing, recruiting).
Therapeutic area(s): Diseases [C] - Skin and Connective Tissue Diseases [C17]
Gender: Female, Male. Age: 18-64 years. Enrolment: 118.
Status: Ongoing, recruiting. Start date (EU): 2026-04-10. Decision date: 2026-03-24. Results received: No. Last updated: 2026-03-30.
Decision dates by country: BG: 2026-03-30, DE: 2026-03-25, RO: 2026-03-30, ES: 2026-03-25, PL: 2026-03-24

Condition(s): Alopecia areata
Product: Placebo for LAD603, LAD603

Primary endpoint: Percent change from baseline in the SALT score, at Week 28.

Source: https://euclinicaltrials.eu/ctis-public/view/2025-523342-27-00